EU clinical trial 2024-514917-36-00: HR-NBL2: High-risk neuroblastoma study 2.0 of SIOP-Europe- Neuroblastoma/SIOPEN : Randomised, international and multicentric phase 3 study that evaluates 3 therapeutic phases (induction, high-dose chemotherapy and radiotherapy) for patients with high-risk neuroblastoma, and introduces chemoimmunotherapy for patients with insufficient metastatic response after induction chemotherapy
Protocol code: 2019/2894
Sponsor: Institut Gustave Roussy (Hospital/Clinic/Other health care facility). Phase: Therapeutic confirmatory (Phase III). Countries: Netherlands (ongoing, recruiting), Spain (ongoing, recruiting), Denmark (ongoing, recruiting), Norway (ongoing, recruiting), Germany (ongoing, recruiting), Czechia (ongoing, recruiting), France (ongoing, recruiting), Belgium (ongoing, recruiting), Slovenia (ongoing, recruiting), Greece (ongoing, recruiting), Italy (ongoing, recruiting), Austria (ongoing, recruiting), Slovakia (authorised, recruiting), Finland (authorised, recruitment pending), Hungary (authorised, recruitment pending), Lithuania (authorised, recruitment pending).
Therapeutic area(s): Diseases [C] - Neoplasms [C04]
Gender: Female, Male. Age: 0-17 years, 18-64 years. Enrolment: 920.
Start date (EU): 2024-11-21. Decision date: 2024-11-21. Results received: No. Last updated: 2026-08-05.
Decision dates by country: FR: 2024-11-21, ES: 2024-11-21, CZ: 2024-11-25, NO: 2024-11-21, DE: 2024-11-25, AT: 2024-11-26, SI: 2024-11-25, IT: 2024-12-18, DK: 2024-11-21, BE: 2024-11-21, GR: 2025-01-17, NL: 2024-11-22, SK: 2024-11-26, FI: 2026-07-16, HU: 2026-07-15, LT: 2026-08-05

Condition(s): Patients with High Risk Neuroblastoma
Product: Busulfan 6 mg/ml concentrate for solution for infusion, Qarziba 4.5 mg/mL concentrate for solution for infusion, Melphalan 50 mg concentrate and solvent for solution for injection/infusion, Irinotecan Hydrochloride 20 mg/mL concentrate for solution for infusion, Temodal 100 mg hard capsules, Vincristine Sulfate 1 mg/ml solution for injection, Thiotepa 15 mg Powder for solution for injection , Cisplatin 1 mg/ml concentrate for solution for infusion, Cyclophosphamide Injection 500 mg., Etoposide 20 mg/ml Concentrate for Solution for Infusion, CARBOPLATINE MEDAC 10 mg/mL, solution à diluer pour perfusion

Primary endpoint: R-HDC: 3-year EFS from the date of R-HDC randomisation R-RTx: 3-year EFS from the date of RTx randomization Chemoimmunotherapy arm: Metastatic response rate after 4 cycles of TEMIRI/DB. All analyses for randomized trials will be performed considering patients in the treatment group defined by randomization (intention to treat). The primary analysis will be controlled for stratification factors
Endpoint(s): For the whole population of high-risk neuroblastoma: - 3- and 5-year EFS, PFS and OS calculated from diagnosis, For each randomized treatment: -5-year EFS, 3- and 5-year PFS and OS calculated from the date of each randomisation/ arm inclusion - Cumulative incidence of relapse/progression -Cumulative incidence of treatment related mortality and of disease related mortality - Overall and metastatic response as per the new INRG response criteria (including primary tumour after induction), skeletal response on mIBG, bone marrow response, local control - Therapy-related toxicity, For patients in the chemoimmunotherapy arm: - Metastatic reponse rate after 2 cycles TEMIRI/DB and 3- and 5- year EFS/PFS/OS from the date of initial diagnosis

Source: https://euclinicaltrials.eu/ctis-public/view/2024-514917-36-00